EU clinical trial 2024-514857-31-00: Pooled human plasma vs. Crystalloid in the fluid management of children undergoing instrumented spinal fusion for scoliosis. A double-blind, randomized clinical trial.
Sponsor: HUS-Yhtymae (Hospital/Clinic/Other health care facility). Phase: Therapeutic exploratory (Phase II). Countries: Finland (ongoing, recruiting).
Therapeutic area(s): Diseases [C] - Musculoskeletal Diseases [C05]
Gender: Female, Male. Age: 0-17 years, 18-64 years. Enrolment: 90.
Status: Ongoing, recruiting. Start date (EU): 2025-05-02. Decision date: 2024-11-12. Results received: No. Last updated: 2025-01-16.
Decision dates by country: FI: 2025-01-16

Condition(s): Neuromuscular scoliosis (NMS), Adolescent idiopathic scoliosis (AIS)
Product: Plasma-Lyte® 148 (pH 7.4) solution for infusion., octaplasLG infuusiokuiva-aine ja liuotin, liuosta varten

Primary endpoint: Primary outcome is the intraoperative blood loss (blood loss in mL after wound closure).
Endpoint(s): Secondary outcomes include need for allogenic red blood cell infusion (percentage of patients at hospital release, health-related quality of life (Scoliosis Research Society 24 outcome questionnaire), postoperative pain (48-hour opioid consumption, pain visual analogue score), operative time (hours), drain output (mL), hidden blood loss (mL), hospital stay, and complications (skin reactions, TRALI, deep surgical site infection).

Source: https://euclinicaltrials.eu/ctis-public/view/2024-514857-31-00